EU clinical trial 2024-515413-18-00: Folic acid supplement versus placebo for treating mucositis adverse events in metastatic renal cell carcinoma patients receiving targeted therapy (FASTERCC)
Sponsor: Region Midtjylland (Hospital/Clinic/Other health care facility). Phase: Therapeutic exploratory (Phase II). Countries: Denmark (ended).
Therapeutic area(s): Diseases [C] - Neoplasms [C04]
Gender: Female, Male. Age: 18-64 years, 65+ years. Enrolment: 100.
Status: Ended. Start date (EU): 2017-12-22. End date (EU): 2026-05-31. Decision date: 2024-09-10. Results received: No. Last updated: 2024-09-10.

Condition(s): Metastatic renal cell carcinoma (mRCC)
Product: Placebo for Folinsyre 5mg Tabletter MediLink., Folimet, tabletter 5 mg

Primary endpoint: The primary endpoint is the degree of CTCAE mucositis (nasal, oral, pharyngeal, anal, or genital) according to the Common Terminology Criteria for Adverse Events v. 4.0 (CTCAE).
Endpoint(s): The frequency and degree of mucositis (nasal, oral, pharyngeal, anal, or genital) according to patient-reported outcomes (PRO) by self assessment questionnaire using National Comprehensive Cancer Network Functional Assessment of Cancer Therapy Kidney Symptom Index-19 (NCCN-FACT FKSI-19) and a modified version of the M.D. Anderson Symptom Inventory (MDASI) for RCC., The median time to effect of study drug according to CTCAE 4.0 and PRO., The frequency of TKI/mTOR dose reductions in the two groups, The frequency of TKI/mTOR/IT treatment discontinuations in the two groups, The frequency of TKI/mTOR/IT treatment withdrawals in the two groups, The frequency and degree of GI adverse events in the two groups according to CTCAE v. 4.0 and PRO., The frequency and degree of hand-foot syndrome in the two groups according to CTCAE v. 4.0 and PRO., The quality of life in the two groups according to NCCN-FACT FKSI-19 and the M.D. Anderson Symptom Inventory for RCC.

Source: https://euclinicaltrials.eu/ctis-public/view/2024-515413-18-00